EU clinical trial 2024-518147-37-00: Upper-limb Active Function and Botulinum Toxin A
Protocol code: RC31/17/0455
Sponsor: Centre Hospitalier Universitaire De Toulouse (Hospital/Clinic/Other health care facility). Phase: Therapeutic exploratory (Phase II). Countries: France (authorised, recruitment pending).
Therapeutic area(s): Diseases [C] - Nervous System Diseases [C10]
Gender: Female, Male. Age: 18-64 years, 65+ years. Enrolment: 80.
Status: Authorised, recruitment pending. Decision date: 2024-10-31. Results received: No. Last updated: 2024-10-31.

Condition(s): Stroke
Product: Dysport 500 U, poudre pour solution injectable

Primary endpoint: Measurement of the spastic cocontraction index (ICCS) during active elbow extension movement, obtained from the EMG signal of the elbow extensor and flexor muscles on the paretic side, between T1 and T2 (before versus 4 weeks after TBA injection)
Endpoint(s): Spasticity of the elbow flexors according to Tardieu, Limitation of the active movement angle (LAMA) of elbow extension, Fugl-Meyer score (motor selectivity), Functional abilities with the Wolf Motor Function Test (WMFT) score, EEG quantification of bilateral cortical activity during movement (real or imagined) to calculate the following indices: o desynchronization index (ERD) identifying hyperactivity in the ipsilesional cortex; o synchronization index quotient (ERS) to assess interhemispheric inhibition (inhibition laterality coefficient) o amount of interhemispheric coherence, Corticospinal excitability (curve of variation of MEP amplitude as a function of stimulation intensity) assessed by TMS, Anatomical lesions of the motor pathways (motor cortex and descending motor pathways) obtained from anatomical (T1) and diffusion-weighted MRI

Source: https://euclinicaltrials.eu/ctis-public/view/2024-518147-37-00